EU clinical trial 2024-519936-18-00: Intrathecal MRI Contrast for Assessment of CSF Transport
Protocol code: 2015/96 MRI contrast
Sponsor: Oslo University Hospital HF (Hospital/Clinic/Other health care facility). Phase: Therapeutic use (Phase IV). Countries: Norway (ongoing, recruiting).
Therapeutic area(s): Diseases [C] - Nervous System Diseases [C10]
Gender: Female, Male. Age: 18-64 years, 65+ years. Enrolment: 1000.
Status: Ongoing, recruiting. Start date (EU): 2025-01-29. Decision date: 2025-01-28. Results received: No. Last updated: 2026-03-26.

Condition(s): CSF disorders, Cognitive impairment, CNS neoplasia, Hydrocephalus, Fatigue
Product: GADOBUTROL

Primary endpoint: MRI evidence of CSF flow Blood-based determination of CSF clearance
Endpoint(s): Quantitative estimation of CSF flow and clearance

Source: https://euclinicaltrials.eu/ctis-public/view/2024-519936-18-00